EU clinical trial 2023-508005-24-00: A Global Multicenter, Open Label, Randomized Phase 3 Registrational Study of Lisaftoclax (APG-2575) in Previously Treated Patients with Chronic Lymphocytic Leukemia/Small Lymphocytic Lymphoma (GLORA Study)
Protocol code: APG2575CG301
Sponsor: Ascentage Pharma Group Inc. (Pharmaceutical company). Phase: Therapeutic confirmatory (Phase III). Countries: Italy (ongoing, recruiting), Germany (authorised, recruiting), Poland (ongoing, recruiting), Hungary (authorised, recruiting), Czechia (ongoing, recruiting), Romania (ongoing, recruiting), Slovakia (ongoing, recruiting), France (ongoing, recruiting), Bulgaria (ongoing, recruiting), Spain (ongoing, recruiting), Belgium (ongoing, recruiting).
Therapeutic area(s): Diseases [C] - Hemic and Lymphatic Diseases [C15]
Gender: Female, Male. Age: 18-64 years, 65+ years. Enrolment: 259.
Start date (EU): 2024-08-01. Decision date: 2024-05-13. Results received: No. Last updated: 2026-07-06.
Decision dates by country: IT: 2024-05-14, FR: 2024-05-16, BE: 2024-09-12, ES: 2024-05-16, SK: 2024-05-13, RO: 2024-05-20, HU: 2024-05-14, DE: 2024-05-14, BG: 2024-05-20, PL: 2024-05-20, CZ: 2024-05-16

Condition(s): Chronic Lymphocytic Leukemia/Small Lymphocytic Lymphoma
Product: Calquence 100 mg film-coated tablets, Lisaftoclax, BRUKINSA 80 mg hard capsules, Lisaftoclax, Lisaftoclax, IMBRUVICA 140 mg hard capsules, Calquence 100 mg film-coated tablets, IMBRUVICA 140 mg film-coated tablets, IMBRUVICA 140 mg hard capsules, Calquence 100 mg hard capsules, Calquence 100 mg hard capsules, IMBRUVICA 140 mg film-coated tablets

Primary endpoint: PFS assessed by IRC defined as the time from randomization to the first occurrence of progression or relapse using the iwCLL guidelines (Hallek Metal 2018) or death from any cause, whichever occurs first.
Endpoint(s): Key secondary endpoint: Overall survival (OS) defined as the time from randomization to the time of death from any cause., Other secondary efficacy endpoints: PFS assessed by investigator is defined as the time from randomization to the first occurrence of progression or relapse using the iwCLL guidelines (Hallek Metal 2018) or death from any cause, whichever occurs first., Other secondary efficacy endpoints: Overall response rate (ORR) is defined as the proportion of patients with complete response (CR), complete response with incomplete recovery (CRi) and partial repose (PR)., Other secondary efficacy endpoints: Proportion of patients with CR/CRi., Other secondary efficacy endpoints: Duration of Response., Other secondary efficacy endpoints: Proportion of patients with undetectable minimal residual disease., Safety endpoints: Incidence and severity of adverse events, serious adverse events and changes in laboratory results, including hematology and biochemistry, during and within 30 days of treatment discontinuation., Safety endpoints: Incidence of adverse events of interest, including atrial fibrillation and tumor lysis syndrome., Pharmacokinetics endpoint: Population PK analysis., Patient-Reported Outcome (PRO) Measures endpoint: The PRO outcome measures will evaluate the European Organization for Research and Treatment of Cancer (EORTC), Quality of Life Questionnaire Core-30 (QLQ-C30) and associated CLL module (QLQ-CLL17)., Health Economics and Outcomes Research (HEOR) endpoint: A EuroQoL5-Dimension (EQ-5D-5L) questionnaire will be used

Source: https://euclinicaltrials.eu/ctis-public/view/2023-508005-24-00